EU clinical trial 2023-505780-37-00: A Randomized, Double-Blind (Sponsor-Unblinded), Placebo-Controlled, Adaptive Study to Investigate the Antiviral Effect, Safety, Tolerability and Pharmacokinetics of VH3739937 in Treatment-Naïve Adults Living with HIV-1
Protocol code: 212580
Sponsor: Viiv Healthcare UK Limited (Pharmaceutical company). Phase: Therapeutic exploratory (Phase II). Countries: Poland (ended), Italy (ended), Greece (ended), Spain (ended).
Therapeutic area(s): Diseases [C] - Virus Diseases [C02]
Gender: Female, Male. Age: 18-64 years, 65+ years. Enrolment: 18.
Status: Ended. Start date (EU): 2023-12-21. End date (EU): 2025-03-17. End date: 2025-03-18. Decision date: 2023-12-12. Results received: Yes. Last updated: 2024-11-22.
Decision dates by country: IT: 2023-12-13, ES: 2023-12-12, PL: 2023-12-14, GR: 2023-12-18

Condition(s): HIV Infections
Product: Placebo for GSK3739937 Tablets are tablets for oral administration and visually match the active GSK3739937 Tablets with the omission of the active ingredient. Placebo for GSK3739937 Tablets are white, round, film coated tablets containing no markings.

Primary endpoint: Maximum change from baseline (Day 1) in plasma HIV-1 RNA through Day 8
Endpoint(s): Incidence of SAEs, Deaths and AEs leading to Discontinuation through Day 8, VH3739937 PK parameters : Following QD dosing: • Day 1: Cmax, tmax, C24 and AUC(0 24) • Day 7: Cmax,ss, tmax, C24,ss and AUC(0-24),ss Following single dose: Cmax, tmax, AUC(0-168) and C168

Source: https://euclinicaltrials.eu/ctis-public/view/2023-505780-37-00